EU clinical trial 2023-509059-15-00: First-in-human, open-label, dose-escalation trial with expansion cohorts to evaluate safety of GEN1046 in subjects with malignant solid tumors
Protocol code: GCT1046-01
Sponsor: Genmab A/S (Pharmaceutical company). Phase: Phase I and Phase II (Integrated)- First administration to humans. Countries: Poland (ended), Spain (ended), Italy (ended), Hungary (ended).
Therapeutic area(s): Diseases [C] - Neoplasms [C04]
Gender: Female, Male. Age: 18-64 years, 65+ years. Enrolment: 295.
Status: Ended. Start date (EU): 2019-04-30. End date (EU): 2026-07-09. Decision date: 2024-07-23. Results received: No. Last updated: 2026-06-11.
Decision dates by country: HU: 2024-07-23, IT: 2024-07-29, PL: 2024-08-04, ES: 2024-07-24

Condition(s): Malignant solid tumors: endometrial carcinoma (EC), urothelial carcinoma (UC), triple-negative breast cancer (TNBC), squamous cell carcinoma of the head and neck (SCCHN), or cervical cancer.
Product: KEYTRUDA 25 mg/mL concentrate for solution for infusion, Cisplatin 1mg/ml Injection BP, Carboplatin 10 mg/ml Intravenous Infusion, Pemetrexed Accord 100 mg powder for concentrate for solution for infusion., Abraxane 5 mg/ml powder for dispersion for infusion., Abraxane 5 mg/ml powder for dispersion for infusion., Acasunlimab, Pazenir 5 mg/ml powder for dispersion for infusion.

Primary endpoint: 1. Dose Escalation: Number of Participants With Dose Limiting Toxicity (DLT) Toxicities will be graded for severity according to Common Terminology Criteria for Adverse Events (CTCAE) criteria version 5.0., 2. Dose Escalation and Monotherapy Expansion Cohorts: Number of Participants With Adverse Events (AEs), 3. Dose Escalation and Monotherapy Expansion Cohorts: Number of Participants With Shifts From Baseline in Safety Laboratory Parameters, 4. Expansion Cohort 1: Objective Response Rate (ORR) ORR is defined as the percentage of participants with best overall response (BOR) of complete response (CR) or partial response (PR) based on response evaluation criteria in solid tumours (RECIST).
Endpoint(s): 5. Expansion Cohort 1: Number of Participants With AEs, 6. Expansion Cohort 1: Number of Participants With Shifts From Baseline in Safety Laboratory Parameters, 7. Combination Therapy Expansion Cohorts: Number of Participants With AEs, 8. Combination Therapy Expansion Cohorts: Number of Participants With Shifts From Baseline in Safety Laboratory Parameters, 9. All Parts: Total Body Clearance (CL) of GEN1046, 10. All Parts: Volume of Distribution (Vd) of GEN1046, 11. All Parts: Area Under the Concentration-Time Curve from Time Zero to Day 21 (AUC21days) of GEN1046, 12. All Parts: Area Under the Concentration-Time Curve from Time Zero to Infinity (AUCinf) of GEN1046, 13. All Parts: Area Under the Concentration-Time Curve from Time Zero to Last Quantifiable Concentration (AUClast) of GEN1046, 14. All Parts: Maximum Observed Plasma Concentration (Cmax) of GEN1046, 15. All Parts: Time to Reach Cmax (Tmax) of GEN1046, 16. All Parts: Elimination Half-life (t½) of GEN1046, 17. All Parts: Number of Participants with Anti-drug Antibodies (ADAs) Venous blood samples will be collected for measurement of serum concentrations of ADAs., 18. Dose Escalation and Expansion Cohorts 2, 3, 4, 5, 6, 7, 8, 9, 10, 11, 12, 13: ORR ORR is defined as the percentage of participants with BOR of CR or PR based on RECIST v1.1., 19. Dose Escalation and Expansion Cohorts 2, 3, 4, 5, 6, 7, 8, 9, 10, 11, 12, 13: Disease Control Rate (DCR) The DCR is defined as the percentage of participants with confirmed BOR of CR, PR, or Stable Disease (SD) according to RECIST v1.1., 20. All Parts: Duration of Response (DoR) DOR is defined as the time from first documentation of response (CR or PR) to the date of the first documented progression or death whichever occurs earlier based on RECIST v1.1., 21. Expansion Cohort 1: Progression Free Survival (PFS) PFS is defined as the number of days from Day 1 in Cycle 1 to the first documented progression or death due to any cause, whichever occurs first based on RECIST version 1.1., 22. Expansion Cohort 1: Overall survival (OS) OS is defined as the number of days from Day 1 in Cycle 1 to death due to any cause.

Source: https://euclinicaltrials.eu/ctis-public/view/2023-509059-15-00